EU clinical trial 2023-509604-15-00: A Phase 1b, Open-label Study to Evaluate the Safety, Tolerability, Pharmacokinetics, Immunogenicity, and Antitumor Activity of MEDI5752 in Combination with Axitinib in Subjects with Advanced Renal Cell Carcinoma
Sponsor: AstraZeneca AB (Pharmaceutical company). Phase: Human Pharmacology (Phase I)- Other. Countries: Spain (ongoing, recruitment ended), France (ended).
Therapeutic area(s): Diseases [C] - Neoplasms [C04]
Gender: Female, Male. Age: 18-64 years, 65+ years. Enrolment: 93.
Start date (EU): 2021-02-15. Decision date: 2024-06-05. Results received: No. Last updated: 2025-11-20.
Decision dates by country: FR: 2024-09-23, ES: 2024-06-05

Condition(s): Advanced Renal Cell Carcinoma
Product: LENVIMA 4 mg hard capsules, volrustomig, Kisplyx 10 mg hard capsules, Kisplyx 4 mg hard capsules, LENVIMA 10 mg hard capsules

Primary endpoint: "Safety • Incidence of adverse events (AEs)/serious adverse events (SAEs) • Dose-limiting toxicities (DLTs) • AEs leading to discontinuation of treatment • Abnormal laboratory parameters, vital signs, electrocardiogram (ECG) results Efficacy • Objective response rate (ORR) per Response Evaluation Criteria in Solid Tumors (RECIST) version (v) 1.1"
Endpoint(s): "Efficacy • Progression-free survival (PFS), best overall response (BOR), disease control rate (DCR), duration of response (DoR), and time to response (TTR) per RECIST v1.1 Pharmacokinetics • Concentration of MEDI5752 in serum Immunogenicity • Incidence of antidrug antibodies (ADAs) against MEDI5752 in serum "

Source: https://euclinicaltrials.eu/ctis-public/view/2023-509604-15-00